EU clinical trial 2024-519814-29-00: A Multicenter, Randomized, Open-label, Phase 2 Study Evaluating the Safety and Efficacy of Navlimetostat (BMS986504) Monotherapy in Participants with Advanced or Metastatic Non-small Cell Lung Cancer (NSCLC) with Homozygous MTAP Deletion After Progression on Prior Therapies
Protocol code: CA240-0009
Sponsor: Bristol-Myers Squibb Services Unlimited Company (Pharmaceutical company). Phase: Therapeutic exploratory (Phase II). Countries: Germany (ongoing, recruiting), Spain (ongoing, recruiting), France (ongoing, recruiting), Sweden (ongoing, recruiting), Poland (authorised, recruiting), Italy (ongoing, recruiting), Romania (ongoing, recruiting).
Therapeutic area(s): Diseases [C] - Neoplasms [C04]
Gender: Female, Male. Age: 18-64 years, 65+ years. Enrolment: 74.
Start date (EU): 2025-09-12. Decision date: 2025-08-01. Results received: No. Last updated: 2026-05-18.
Decision dates by country: FR: 2025-08-01, IT: 2025-08-12, ES: 2025-08-06, PL: 2025-08-11, SE: 2025-08-01, RO: 2025-11-10, DE: 2025-08-05

Condition(s): Advanced or Metastatic Non-small Cell Lung Cancer
Product: MRTX1719

Primary endpoint: Number of participants who achieve Objective Response (OR) utilizing the Response Evaluation Criteria in Solid Tumors (RECIST) v1.1
Endpoint(s): Number of participants who achieve disease control (DC) as assessed by RECIST v1.1, Duration of response (DOR) as assessed by RECIST v1.1, Progression-free survival (PFS) as assessed by RECIST v1.1, Time to objective response (TTOR) as assessed by RECIST v1.1, Number of participants with adverse events (AE), Number of participants with Serious AEs (SAEs), Number of participants with AEs leading to dose interruption, reduction, or discontinuation, Number of participants who achieve Objective Response (OR) as assessed by RECIST v1.1, Overall Survival, Change from baseline in cancer-related symptoms and health-related quality of life as assessed by the Non-small Cell Lung Cancer Symptom Assessment Questionnaire (NSCLC-SAQ) total score and symptom score, Change from baseline in cancer-related symptoms and health-related quality of life as assessed by the EORTC-QLQ-F17 quality-of-life (QoL) functional scale score

Source: https://euclinicaltrials.eu/ctis-public/view/2024-519814-29-00